EU clinical trial 2024-512628-12-00: CXCR4-directed [68Ga]Ga-PentixaFor PET/CT vs AVS performance in a diagnoStic randomized Trial Ultimately comparing hypertenSion outcome in primary aldosteronism (CASTUS trial)
Sponsor: Stichting Radboud universitair medisch centrum (Hospital/Clinic/Other health care facility). Phase: Phase II and Phase III (Integrated). Countries: Netherlands (ongoing, recruiting).
Therapeutic area(s): Diseases [C] - Cardiovascular Diseases [C14]; Analytical, Diagnostic and Therapeutic Techniques and Equipment [E] - Diagnosis [E01]; Analytical, Diagnostic and Therapeutic Techniques and Equipment [E] - Investigative Techniques [E05]; Diseases [C] - Hormonal diseases [C19]
Gender: Female, Male. Age: 18-64 years, 65+ years. Enrolment: 228.
Status: Ongoing, recruiting. Start date (EU): 2025-01-28. Decision date: 2024-08-01. Results received: No. Last updated: 2025-10-08.

Condition(s): Primary aldosteronism
Product: [68Ga]Ga-PentixaFor

Primary endpoint: To assess the concordance between [68Ga]Ga-PentixaFor PET/CT and AVS for identification and/or lateralization of APAs in patients with PA. (Step 1), To assess non-inferiority in terms of clinical outcomes of [68Ga]Ga-PentixaFor PET/CT imaging vs. AVS in subtyping of patients with PA randomized to either [68Ga]Ga-PentixaFor PET/CT imaging or AVS confirmed by the surrogate Standard of Truth (SoT) daily defined doses (DDD) in patients after 6 months follow-up. (Step 2)
Endpoint(s): To establish definitive quantitative criteria of [68Ga]Ga-PentixaFor uptake in unilateral and bilateral PA for SUVs, liver-to-lesion ratio and lesion-to-contralateral ratio. (step 1), In patients who receive unilateral adrenalectomy, compare quantitative data in PET/CT imaging between immunohistochemically (CYP11B2 and CXCR4 staining) diagnosed multinodular hyperplasia and solitary adenomas. (step 1), To assess biochemical and clinical outcomes based on PASO criteria (step 1), To asses biochemical and clinical outcomes after adrenalectomy of [68Ga]Ga-PentixaFor PET/CT imaging vs AVS in subtyping patients with PA by using the PASO criteria for clinical and biochemical outcome measures (complete, partial or absent). (step2), To evaluate reproducibility of [68Ga]Ga-PentixaFor PET/CT by comparison of two [68Ga]Ga-PentixaFor PET/CT scans with an interval of 1-14 days in the first 10 patients undergoing [68Ga]Ga-PentixaFor PET/CT. (step 2), To assess intra- and inter-reader agreement of [68Ga]Ga-PentixaFor PET/CT for subtyping for each imaging center (step 2), To analyze inter-observer agreement of [68Ga]Ga-PentixaFor PET/CT between the imaging centers in terms of subtyping. (step 2), In patients who receive unilateral adrenalectomy, compare quantitative data in PET/CT imaging between immunohistochemically (CYP11B2 and CXCR4 staining) diagnosed multinodular hyperplasia and solitary adenomas. (step 2), To perform cost effectiveness analysis of AVS versus [68Ga]Ga-PentixaFor PET/CT management. (step 2), To evaluate quality of life as assessed by EQ-5D-5L questionnaire and the Short Form health survey (SF36) of [68Ga]Ga-PentixaFor PET/CT versus AVS management. (step 2), Determination of the rate of inconclusive results and/or failure of subtype diagnosis by [68Ga]Ga-PentixaFor PET/CT imaging or AVS. (step 2), To assess safety and intolerability. (step 2), To assess image quality of [68Ga]Ga-PentixaFor PET/CT imaging, using the SUVmean, SUVmax, and SUVpeak, lesion-to-liver ratio, contrast-to-noise ratio, and signal-to-noise ratio. (step 2), To assess biochemical and clinical outcomes in patients treated with antihypertensive drugs based on [68Ga]Ga-PentixaFor PET/CT imaging vs AVS in subtyping PA by using the PAMO criteria for clinical and biochemical outcome measures (complete, partial or absent) (currently unpublished data).

Source: https://euclinicaltrials.eu/ctis-public/view/2024-512628-12-00